EU clinical trial 2024-519327-20-00: A study to test how well multiple doses of BI 3810477 are tolerated by healthy adults.
Protocol code: 1530-0002
Sponsor: Boehringer Ingelheim International GmbH (Pharmaceutical company). Phase: Human Pharmacology (Phase I)- Other. Countries: Belgium (ended).
Therapeutic area(s): Not possible to specify
Gender: Female, Male. Age: 18-64 years. Enrolment: 48.
Status: Ended. Start date (EU): 2025-05-21. End date (EU): 2026-03-09. Decision date: 2025-04-03. Results received: No. Last updated: 2026-02-09.

Condition(s): Healthy volunteer trial

Source: https://euclinicaltrials.eu/ctis-public/view/2024-519327-20-00